EU clinical trial 2023-508826-92-00: A phase Ib study of Ipatasertib, an AKT inhibitor, in combination with Pertuzumab plus Trastuzumab in patients with PIK3CA-mutant, HER2-positive locally advanced or metastatic breast cancer.
Protocol code: SOLTI-1507
Sponsor: Solti Group (Pharmaceutical company). Phase: Human Pharmacology (Phase I)- Other. Countries: Spain (ended).
Therapeutic area(s): Diseases [C] - Neoplasms [C04]
Gender: Female, Male. Age: 18-64 years, 65+ years. Enrolment: 26.
Status: Ended. Start date (EU): 2020-02-14. End date (EU): 2025-06-17. Decision date: 2024-06-25. Results received: Yes. Last updated: 2025-03-05.

Condition(s): Patients with PIK3CA-mutant, HER2-positive locally advanced or metastatic breast cancer, candidates to receive maintenance therapy with trastuzumab plus pertuzumab (HP) after first line treatment for metastatic disease with a taxane or vinorelbine plus HP.
Product: Herceptin 600 mg solution for injection in vial, Perjeta 420 mg concentrate for solution for infusion, Ipatasertib, Ipatasertib, Herceptin 150 mg powder for concentrate for solution for infusion

Primary endpoint: Determination of the Maximum Tolerated Dose (MDT), defined as the highest dose level at which no more than 1 of 6 subjects experiences a DLT during the DLT assessment window (28 days), and recommended phase 2 dose (RP2D), as assessed by the Steering Committee.
Endpoint(s): For A): - Overall incidence and severity of adverse events (AEs) and severe adverse events (SAEs) as per NCI CTCAE v4.03 of the combination of ipatasertib plus HP (+/- ET), with a special emphasis on the onset and severity of diarrhea., For B): - Objective Response Rate (ORR), defined as the proportion of patients who have a complete response (CR) or partial response (PR), as determined by the investigator through use of RECIST v1.1.This endpoint will only be determined in patients without CR after taxane or vinorelbine + HP induction therapy, Duration of Response (DoR), defined as the time from the first occurrence of a documented Objective Response (OR) to disease progression, according to RECIST v1.1, or death from any cause, whichever occurs first.This endpoint will only be determined in patients without CR after taxane or vinorelbine + HP induction therapy., Clinical Benefit Rate (CBR) defined as the percentage of patients achieving confirmed CR, PR or stable disease (SD) for at least 24 weeks after the beginning of the study treatment by RECIST v1.1., Progression-free survival (PFS), defined as the time from the commencement of study treatment (Day 1) to the occurrence of PD, as determined by the investigator via RECIST v1.1, or death from any cause, whichever occurs first., Safety: incidence of Dose Limiting Toxicity (DLT) in the evaluation period., Tolerability: dose interruptions, reductions, and dose intensity

Source: https://euclinicaltrials.eu/ctis-public/view/2023-508826-92-00